EU clinical trial 2023-509516-28-00: A multi-site, open-label, Phase II, randomized, controlled trial to compare the efficacy of RO7198457 versus watchful waiting in resected, Stage II (high risk) and Stage III colorectal cancer patients who are ctDNA positive following resection
Protocol code: BNT122-01
Sponsor: BioNTech SE (Pharmaceutical company). Phase: Therapeutic exploratory (Phase II). Countries: Germany (ongoing, recruitment ended), Spain (ongoing, recruitment ended), Sweden (ongoing, recruitment ended), Belgium (ongoing, recruitment ended).
Therapeutic area(s): Diseases [C] - Neoplasms [C04]
Gender: Female, Male. Age: 18-64 years, 65+ years. Enrolment: 188.
Status: Ongoing, recruitment ended. Start date (EU): 2021-02-22. Decision date: 2024-02-23. Results received: No. Last updated: 2025-11-06.
Decision dates by country: ES: 2024-03-06, BE: 2024-03-11, SE: 2024-02-23, DE: 2024-02-28

Condition(s): Stage II/Stage III rectal cancer or Stage II (high risk)/Stage III colon cancer
Product: Watchful waiting, RO7198457 (autogene cevumeran)

Primary endpoint: Disease-free survival (DFS) defined as the time from randomization to occurrence of any of the following events, whichever occurs first: Locoregional recurrence or distant metastases as determined by an independent central radiology assessment. Occurrence of second primary (same or other) cancer as determined by an independent central radiology assessment. Death from any cause. Loss to follow-up is censored.
Endpoint(s): Relapse-free survival (RFS) is defined as the time from randomization to occurrence of any of the following events, whichever occurs first: Locoregional recurrence or distant metastases as determined by the investigator. Death from any cause. Occurrence of second primary (same or other) cancer as determined by the investigator is ignored. Loss to follow-up is censored., Time to recurrence (TTR) is defined as the time from randomization to occurrence of any of the following events (i.e., events related to the same cancer), whichever occurs first: Locoregional recurrence or distant metastases as determined by the investigator. Death from same cancer. Occurrence of second primary (same or other) cancer as determined by the investigator is ignored. Loss to follow-up and deaths from other cancer, non-cancer-related deaths, treatment-related deaths are censored., Time to treatment failure (TTF) is defined as the time from randomization to occurrence of any of the following events, whichever occurs first: Locoregional recurrence or distant metastases as determined by the investigator. Occurrence of second primary (same or other) cancer as determined by the investigator. Death from any cause except non-cancer-related death. Loss to follow-up and non–cancer-related deaths are censored., Overall survival (OS) defined as the time from randomization to death from any cause. Change of ctDNA status (approx. every 3 months)., Occurrence of treatment-emergent adverse events (TEAEs), including Grade 3+, serious, fatal TEAEs by relationship. Occurrence of dose reduction and discontinuation of RO7198457 due to a TEAE., Change of ctDNA status (approx. every 3 months).

Source: https://euclinicaltrials.eu/ctis-public/view/2023-509516-28-00